EU clinical trial 2022-501506-36-00: A Phase 3 Randomized, Open-label Clinical Study to Evaluate the Pharmacokinetics and Safety of Subcutaneous Pembrolizumab Coformulated With Hyaluronidase (MK-3475A) Versus Intravenous Pembrolizumab, Administered With Chemotherapy, in the First-line Treatment of Participants With Metastatic Non-small Cell Lung Cancer
Protocol code: MK3475A-D77
Sponsor: Merck Sharp & Dohme LLC (Pharmaceutical company). Phase: Therapeutic confirmatory (Phase III). Countries: Poland (ongoing, recruitment ended), Romania (ongoing, recruitment ended), Spain (ongoing, recruitment ended), France (ended), Hungary (ongoing, recruitment ended).
Therapeutic area(s): Diseases [C] - Neoplasms [C04]
Gender: Female, Male. Age: 18-64 years, 65+ years. Enrolment: 100.
Start date (EU): 2023-04-11. Decision date: 2023-04-04. Results received: No. Last updated: 2026-07-02.
Decision dates by country: FR: 2023-04-05, RO: 2023-04-18, PL: 2023-04-17, HU: 2023-04-06, ES: 2023-04-04

Condition(s): First-line treatment of participants with metastatic nonsmall cell lung cancer
Product: Cisplatin Teva® 1 mg/ml Konzentrat zur Herstellung einer Infusionslösung, KEYTRUDA 25 mg/mL concentrate for solution for infusion, Pazenir 5 mg/ml powder for dispersion for infusion, CARBOPLATIN, CISPLATIN, Paclitaxel EVER Pharma 6 mg/ml Konzentrat zur Herstellung einer Infusionslösung, Carboplatin Kabi 10 mg/ml Konzentrat zur Herstellung einer Infusionslösung, PACLITAXEL, MK-3475A, PACLITAXEL ALBUMIN-BOUND, PEMETREXED, PEGFILGRASTIM, FILGRASTIM, ALIMTA 500 mg powder for concentrate for solution for infusion

Primary endpoint: Area Under the Curve (AUC) of Pembrolizumab Measured After the First Dose, Trough Concentration (Ctrough) of Pembrolizumab Measured at Steady State
Endpoint(s): Maximum Serum Concentration (Cmax) of Pembrolizumab Measured After the First Dose, Trough Concentration (Ctrough) of Pembrolizumab Measured After the First Dose, Area Under the Curve (AUC) of Pembrolizumab Measured at Steady State, Maximum Serum Concentration (Cmax) of Pembrolizumab Measured at Steady State, Number of Participants Who Test Positive for Anti-Drug Antibodies (ADAs) for Pembrolizumab, Objective Response Rate (ORR) per Response Evaluation Criteria In Solid Tumors Version 1.1 (RECIST 1.1), Progression-free Survival (PFS) per Response Evaluation Criteria In Solid Tumors Version 1.1 (RECIST 1.1), Overall Survival (OS), Duration of Response (DOR) per Response Evaluation Criteria In Solid Tumors Version 1.1 (RECIST 1.1), Number of Participants Who Experienced at Least One Adverse Event (AE), Number of Participants Who Discontinued Study Treatment Due to an Adverse Event (AE), Change From Baseline in the European Organization for the Research and Treatment of Cancer (EORTC) Quality of Life Questionnaire C30 (QLQ-C30) Global Health Status/Quality of Life (GHS/QoL) Score-Items 29 and 30, Change From Baseline in the European Organization for the Research and Treatment of Cancer (EORTC) Quality of Life Questionnaire C30 (QLQ-C30) Physical Functioning Score-Items 1 to 5, Change From Baseline in the European Organization for the Research and Treatment of Cancer (EORTC) Quality of Life Questionnaire C30 (QLQ-C30) Role Functioning Score-Items 6 and 7

Source: https://euclinicaltrials.eu/ctis-public/view/2022-501506-36-00